EU clinical trial 2025-523487-21-00: An open label, balanced, randomized, two-treatment, two-period, two-sequence, single-dose, crossover, bioequivalence study comparing Maribavir Tablets 200 mg, manufactured by Sun Pharmaceutical Industries Limited, India with LIVTENCITY® (Maribavir) Coated Tablets 200 mg, manufactured by: Catalent CTS, LLC Kansas City, United States of America, packed by: Takeda Ireland Limited Bray, Ireland, imported by: Takeda Pharma Ltda. Highway SP 340 S/N, km 133.5 Jaguariúna Administrative Building -SP CNPJ 60.397.775/0001-74 SAC: 0800 - 7710345, in healthy adult, human subjects under fasting condition.
Protocol code: MARIB-04-25
Sponsor: Sun Pharmaceutical Industries Limited (Pharmaceutical company). Phase: Human Pharmacology (Phase I)- Bioequivalence Study. Countries: Romania (ended).
Therapeutic area(s): Diseases [C] - Virus Diseases [C02]
Gender: Female, Male. Age: 18-64 years. Enrolment: 40.
Status: Ended. Start date (EU): 2026-05-05. End date (EU): 2026-06-03. Decision date: 2026-02-02. Results received: No. Last updated: 2026-05-06.

Condition(s): cytomegalovirus (CMV) infection and/or disease that is refractory (with or without resistance) to one or more prior therapies in adult patients who have undergone hematopoietic stem cell transplantation (HSCT) or solid organ transplantation (SOT)

Source: https://euclinicaltrials.eu/ctis-public/view/2025-523487-21-00